EU clinical trial 2025-524773-16-00: A study in healthy people to compare how 2 different formulations of vicadrostat / empagliflozin tablets are taken up in the body
Protocol code: 1378-0026
Sponsor: Boehringer Ingelheim International GmbH (Pharmaceutical company). Phase: Human Pharmacology (Phase I)- Bioequivalence Study. Countries: Germany (authorised, recruitment pending).
Therapeutic area(s): Not possible to specify
Gender: Female, Male. Age: 18-64 years. Enrolment: 36.
Status: Authorised, recruitment pending. Decision date: 2026-08-06. Results received: No. Last updated: 2026-08-06.

Condition(s): Healthy

Source: https://euclinicaltrials.eu/ctis-public/view/2025-524773-16-00